EU clinical trial 2024-514240-93-00: OBIRINS - Efficacy and Safety of Obinutuzumab versus Rituximab in childhood Steroid Dependant and Frequent Relapsing Nephrotic Syndrome : à double-blind multicenter randomized controlled study
Protocol code: APHP 211038
Sponsor: Assistance Publique Hopitaux De Paris (Hospital/Clinic/Other health care facility). Phase: Phase II and Phase III (Integrated). Countries: France (ongoing, recruiting).
Therapeutic area(s): Diseases [C] - Immune System Diseases [C20]
Gender: Female, Male. Age: 0-17 years. Enrolment: 88.
Status: Ongoing, recruiting. Start date (EU): 2024-10-31. Decision date: 2024-10-31. Results received: No. Last updated: 2025-04-18.

Condition(s): Idiopathic nephrotic syndrome (INS)
Product: OBINUTUZUMAB, RITUXIMAB

Primary endpoint: The primary outcome is the occurrence of a relapse defined as a 3+ proteinuria on dipstick on 3 consecutive days, with 1 laboratory urine dosage of Protein-over-creatinine ratio > 0.20g/mmol (> 0.2g/g), within 12 months following the initiation of Treatment.
Endpoint(s): To assess the superiority of obinutuzumab compared to rituximab on the relapse-free survival at 24-months, To compare the duration of B-cell depletion after OBI and RTX, To compare the relapse-free survival after B-cell recovery after OBI and RTX, To compare the number of relapses, steroid courses and second line treatment strategies required within 24 months in both arms, To compare the safety of the two treatments including infusion-related reactions, infections, levels of immunoglobulins, neutropenia, To assess the factors associated with sustained remission, To assess the cost-effectiveness of the OBI strategy, To assess the budgetary impact of the generalization of the OBI strategy, To assess pharmacokinetics of Obinutuzumab and Rituximab, To assess the development of antidrug antibodies

Source: https://euclinicaltrials.eu/ctis-public/view/2024-514240-93-00